EU clinical trial 2022-501076-26-00: HOVON 151 DLBCL: A phase II study evaluating the feasibility and clinical efficacy of atezolizumab consolidation treatment in high risk diffuse large B-cell lymphoma.
Protocol code: HO151
Sponsor: Hemato-Oncologie voor Volwassenen Nederland (Hovon) Stichting (Hospital/Clinic/Other health care facility). Phase: Therapeutic exploratory (Phase II). Countries: Netherlands (ongoing, recruitment ended), Belgium (ongoing, recruitment ended).
Therapeutic area(s): Diseases [C] - Neoplasms [C04]
Gender: Female, Male. Age: 18-64 years, 65+ years. Enrolment: 109.
Status: Ongoing, recruitment ended. Start date (EU): 2018-08-28. Decision date: 2022-12-15. Results received: No. Last updated: 2025-08-27.
Decision dates by country: BE: 2023-02-10, NL: 2022-12-15

Condition(s): high risk diffuse large B-cell lymphoma
Product: Tecentriq 1,200 mg concentrate for solution for infusion

Primary endpoint: Disease free survival measured from the date of registration to relapse or death from any cause whichever comes first.
Endpoint(s): (Severe) Adverse Events and the relation of adverse events in time to the recovery of the T-cell repertoire., Overall survival, calculated from registration until death from any cause. Patients still alive or lost to follow up are censored at the last date known to be alive., The relationship between MRD status at the end-of-induction and endof- consolidation therapy., The relation between MRD conversion and 2-years DFS and OS., The relationship between T-cell repertoire, PDL1/HLA expression, mutational load, gene immune signature, microbiome and effect of atezolizumab on MRD conversion., The relation between the T-cell and NK cell repertoire and adverse events.

Source: https://euclinicaltrials.eu/ctis-public/view/2022-501076-26-00